EU clinical trial 2024-511659-17-00: 68Ga-FAPI-46 PET-CT for molecular assessment of fibroblast activation and risk assessment in solid tumors (FAPI Basket)
Protocol code: IRST100.59
Sponsor: Istituto Romagnolo Per Lo Studio Dei Tumori Dino Amadori IRST S.r.l. (Hospital/Clinic/Other health care facility). Phase: Therapeutic exploratory (Phase II). Countries: Italy (ongoing, recruiting).
Therapeutic area(s): Diseases [C] - Neoplasms [C04]; Analytical, Diagnostic and Therapeutic Techniques and Equipment [E] - Diagnosis [E01]
Gender: Female, Male. Age: 18-64 years, 65+ years. Enrolment: 200.
Status: Ongoing, recruiting. Start date (EU): 2023-05-01. Decision date: 2024-06-12. Results received: No. Last updated: 2025-09-09.

Condition(s): Solid tumors

Primary endpoint: The primary endpoint is the evaluation of the detection rate of 68Ga-FAPI-46 PET/CT, defined as the proportion of 68Ga-FAPI-46 positive patients and the total number of recruited patients. A positive patient is defined as a patient with at least one 68Ga-FAPI-46 positive lesion. Primary tumor, lymph nodes and metastasis will be considered positive if specific concentration of radioligand in target tissue exceeds the unspecific concentration in adjacent tissues.
Endpoint(s): Proportion of 68Ga-FAPI-46 PET/CT-positive patients over the total number of patients undergoing 68Ga-FAPI-46 PET/CT for each tumor histology, Proportion of 68Ga-FAPI-46 PET/CT-positive patients over the total number of patients undergoing 68Ga-FAPI-46 PET/CT for each lesion site and proportion of 68Ga-FAPI-46 PET/CT-positive lesions over the total number of lesions for each lesion site;, 68Ga-FAPI-46 uptake in terms of SUV, Safety is defined as the number and percentage of patients undergoing grade 1 to 4 adverse events according to CTCAE version 5.0 until 30 days post 68Ga-FAPI-46 PET/CT.

Source: https://euclinicaltrials.eu/ctis-public/view/2024-511659-17-00